EU clinical trial 2025-521717-67-00: Long-Term Follow-up of AvenCell-Sponsored CAR-T Cell Clinical Trials
Protocol code: AVC-PERSIST
Sponsor: Avencell Therapeutics Inc. (Pharmaceutical company). Phase: Human Pharmacology (Phase I)- Other. Countries: Germany (ongoing, recruiting).
Therapeutic area(s): Diseases [C] - Hemic and Lymphatic Diseases [C15]
Gender: Female, Male. Age: 18-64 years, 65+ years. Enrolment: 10.
Status: Ongoing, recruiting. Start date (EU): 2026-01-29. Decision date: 2025-09-08. Results received: No. Last updated: 2025-12-11.

Condition(s): Acute myeloid leukemia

Source: https://euclinicaltrials.eu/ctis-public/view/2025-521717-67-00